EU clinical trial 2025-523283-21-00: J2A-MC-GZPR: A Study to Investigate the Efficacy and Safety of Orforglipron Once Daily in Participants with Peripheral Artery Disease: A Randomized, Double-Blind, Placebo Controlled Trial
Protocol code: J2A-MC-GZPR
Sponsor: Eli Lilly & Co. (Pharmaceutical company). Phase: Therapeutic confirmatory (Phase III). Countries: Slovakia (ongoing, recruiting), Poland (ongoing, recruiting), France (ongoing, recruiting), Netherlands (authorised, recruitment pending).
Therapeutic area(s): Diseases [C] - Cardiovascular Diseases [C14]
Gender: Female, Male. Age: 18-64 years, 65+ years. Enrolment: 185.
Start date (EU): 2026-02-17. Decision date: 2026-02-17. Results received: No. Last updated: 2026-07-28.
Decision dates by country: SK: 2026-02-17, NL: 2026-02-23, FR: 2026-02-17, PL: 2026-02-22

Condition(s): Peripheral Arterial Disease
Product: Orforglipron, Orforglipron, Orforglipron, Orforglipron, Orforglipron, Placebo to match ly, Orforglipron

Primary endpoint: Percent Change from Baseline in Maximum Walking Distance On a constant load treadmill test [Time Frame: Baseline, Week 52]

Source: https://euclinicaltrials.eu/ctis-public/view/2025-523283-21-00